EU clinical trial 2025-522387-32-00: A RANDOMIZED, PHASE 3, OPEN-LABEL STUDY OF NEOADJUVANT DAROVASERTIB IN SUBJECTS WITH PRIMARY NON-METASTATIC UVEAL MELANOMA (OptimUM-10)
Protocol code: IDE196-010
Sponsor: Ideaya Biosciences Inc. (Pharmaceutical company). Phase: Therapeutic confirmatory (Phase III). Countries: France (authorised, recruiting), Spain (ongoing, recruiting), Poland (authorised, recruitment pending), Italy (ongoing, recruiting), Czechia (ongoing, recruiting), Belgium (ongoing, recruiting), Austria (ongoing, recruiting), Netherlands (authorised, recruitment pending), Denmark (authorised, recruiting), Germany (ongoing, recruiting).
Therapeutic area(s): Diseases [C] - Eye Diseases [C11]
Gender: Female, Male. Age: 18-64 years, 65+ years. Enrolment: 297.
Start date (EU): 2026-04-10. Decision date: 2026-01-29. Results received: No. Last updated: 2026-07-31.
Decision dates by country: DK: 2026-02-20, FR: 2026-01-29, CZ: 2026-02-02, BE: 2026-02-02, ES: 2026-02-02, AT: 2026-01-30, DE: 2026-02-25, IT: 2026-02-05, NL: 2026-02-05, PL: 2026-02-08

Condition(s): Uveal Melanoma
Product: IDE196 (LXS196), IDE196 (LXS196)

Primary endpoint: Cohort 1: Proportion of participants with moderate to high risk of visual impairment (MHRVI) with loss of Best Corrected Visual Acuity (BCVA) of ≥ 15 letters using Early Treatment Diabetic Retinopathy Study (ETDRS) BCVA (%VL15) measured from the time of randomization, Cohort 2: Eye preservation rate
Endpoint(s): Cohort 1: ORR_UM by BICR, defined as the rate of best overall response (complete response [CR] or partial response [PR]) Response defined as: o CR: Complete regression of tumor by ultrasound (US) and fundus photography (FP); o PR: Decrease in product of diameters (PoD) by US and/or FP by ≥ 20%, Combined Cohorts 1 and 2: EFS, defined as the time from randomization to the first documented date of treatment failure (including disease progression, local/distant recurrence, or death, whichever occurs first), Combined Cohorts 1 and 2: Incidence of all treatment-emergent AEs (TEAEs), serious adverse events (SAEs) and clinically significant laboratory test abnormalities, and changes to electrocardiograms (ECGs) and vital signs, Combined Cohorts 1 and 2: • Pooled ORR_UM by the Investigator and BICR, Cohort 1: Proportion of participants with clinically significant ME (%ME defined optical coherence tomography [OCT] finding, vision loss, and initiation of vascular endothelial growth factor inhibitor [VEGFi] administration) measured from the time of randomization, Cohort 1: Proportion of participants with 20/200 vision or worse (%20/200) from the time of randomization, Cohort 1: Proportion of participants with significant reduction of radiation dose (defined as a ≥ 20% reduction) delivered to key eye structures including, but not limited to, the macula, optic disc/nerve, and lens, Cohort 1:Proportion of subjects with ME on OCT from the time of completion of PB ME by OCT defined as the presence of intraretinal fluid (cystoid edema) on OCT, ORR_UM by BICR, Cohort 1:Proportion of participants with radiationrelated ocular toxicities at 6, 12, 18, 24, 30, and 36 months post PB • The incidence and severity of radiation induced ocular toxicities

Source: https://euclinicaltrials.eu/ctis-public/view/2025-522387-32-00